EU clinical trial 2024-519359-27-00: A double-blind, randomized, placebo-controlled, two arm, phase II clinical trial in parallel groups to evaluate the efficacy and tolerability of a rectal treatment with budesonide suppositories compared to placebo suppositories for amelioration of acute radiation proctitis symptoms in male patients aged 18 years or older with prostate carcinoma
Protocol code: BUS-006/RAP
Sponsor: Dr. Falk Pharma GmbH (Pharmaceutical company). Phase: Therapeutic exploratory (Phase II). Countries: Germany (ongoing, recruiting), Austria (authorised, recruiting).
Therapeutic area(s): Diseases [C] - Digestive System Diseases [C06]; Diseases [C] - Male Urogenital Diseases [C12]
Gender: Male. Age: 18-64 years, 65+ years. Enrolment: 320.
Start date (EU): 2026-04-16. Decision date: 2026-02-26. Results received: No. Last updated: 2026-07-30.
Decision dates by country: AT: 2026-05-22, DE: 2026-03-06

Condition(s): Acute radiation proctitis symptoms in male patients aged 18 years or older with prostate carcinoma
Product: Budenofalk 4 mg Zäpfchen, placebo to test

Primary endpoint: Time to first improvement in CTCAE grading for proctitis is defined as the number of days from Baseline to the first occurrence of a lower CTCAE grading compared to Baseline, sustained for at least three consecutive days
Endpoint(s): Percentage of participants with reduction in CTCAE grading for proctitis by one and by two score point(s) from Baseline to Visit 2 and Baseline to Visit 4, Time to first improvement in CTCAE grading for diarrhea after Baseline, where improvement is defined as a lower CTCAE grading compared to Baseline for at least three consecutive days, Percentage of participants with reduction in CTCAE grading for diarrhea by one and by two score point(s) from Baseline to Visit 2 and Baseline to Visit 4, Time to first improvement in CTCAE grading for rectal pain after Baseline, where improvement is defined as a lower CTCAE grading compared to Baseline for at least three consecutive days, Percentage of participants with reduction in CTCAE grading for rectal pain by one and by two score point(s) from Baseline to Visit 2 and Baseline to Visit 4, Time to first improvement in each CTCAE grading for further terms of the lower GI composite (fecal incontinence, lower GI hemorrhage, GI pain and other GIdisorder), where improvement is defined as a lower CTCAE grading compared to Baseline for at least three consecutive days, Percentage of participants with reduction in each CTCAE gradings for further terms of the lower GI composite (fecal incontinence, lower GI hemorrhage, GI pain and other GI-disorder) by one and by two score point(s) from Baseline to Visit 2 and Baseline to Visit 4, Course and change from Baseline in the SHS-GI sum score and sub-scores at Visit 2, 4, and 5, Course and change from Baseline in the PGI-S at Visit 2, 4, and 5, PGI-C at Visit 2 and 4, Course and change from Baseline in the EPIC Bowel Domain Score at Visit 2, 4, and 5, Therapeutic success at Visit 4, defined as complete relief or marked improvement of symptoms according to the PGA, Therapeutic benefit at Visit 4, defined as at least a slight improvement according to the PGA, Assessment of efficacy by investigator and participant at Visit 4, Percentage of participants who remained symptom-free for at least ten consecutive days at Visit 4, Percentage of participants who used rescue medication at Visit 4., Duration of rescue medication use at Visit 4, Assessment of tolerability by investigator and participant at Visit 4, Average daily bowel movement frequency within the treatment period, Percentage of days within the treatment period with pain during bowel movements, Percentage of days within the treatment period with mild pain during bowel movements, Percentage of days within the treatment period with moderate pain during bowel movements, Percentage of days within the treatment period with severe pain during bowel movements, Percentage of days within the treatment period with bloody stool, Percentage of days within the treatment period with mucous stool, Percentage of days within the treatment period with uncontrolled bowel movements, Percentage of days within the treatment period during which no pads were used due to uncontrolled bowel movement, Percentage of days within the treatment period during which pads were used sometimes due to uncontrolled bowl movement, Percentage of days within the treatment period during which pads were used most of the time due to uncontrolled bowl movement, Percentage of days within the treatment period during which symptoms interfered with daily life, Percentage of days within the treatment period during which symptoms interfered with daily functioning to the extent that self-care was impossible, Percentage of days within the treatment period during which medical intervention was required due to symptoms

Source: https://euclinicaltrials.eu/ctis-public/view/2024-519359-27-00